EU clinical trial 2024-519646-73-00: A Phase I Randomized, Single-center, Double-blind, Two-period Crossover Trial to Evaluate Pharmacodynamics, Pharmacokinetics, Safety, and Tolerability of Insulin GZR4 Compared with Insulin Icodec in Participants with Type 2 Diabetes.
Protocol code: GL-ULI-1001
Sponsor: Gan & Lee Pharmaceuticals USA Corp. (Pharmaceutical company). Phase: Human Pharmacology (Phase I)- Other. Countries: Germany (ended).
Therapeutic area(s): Diseases [C] - Hormonal diseases [C19]
Gender: Female, Male. Age: 18-64 years, 65+ years. Enrolment: 14.
Status: Ended. End date (EU): 2025-06-10. Decision date: 2025-03-19. Results received: No. Last updated: 2025-03-19.

Condition(s): Type 2 Diabetes Mellitus

Source: https://euclinicaltrials.eu/ctis-public/view/2024-519646-73-00